EU clinical trial 2024-512982-15-00: Roll Over Study for Patients Who Have Completed a Previous Oncology Study with Olaparib and Are Judged by the Investigator to Clinically Benefit From Continued Treatment
Protocol code: D0817C00098
Sponsor: AstraZeneca AB (Pharmaceutical company). Phase: Therapeutic confirmatory (Phase III). Countries: Sweden (ongoing, recruiting), Hungary (ongoing, recruiting), Bulgaria (ongoing, recruiting), Portugal (ongoing, recruiting), Spain (ongoing, recruiting), Belgium (ongoing, recruiting), Czechia (ongoing, recruiting), Germany (ongoing, recruiting), Slovenia (ongoing, recruiting), France (ongoing, recruiting), Italy (ongoing, recruiting), Poland (ongoing, recruiting).
Therapeutic area(s): Diseases [C] - Neoplasms [C04]
Gender: Female, Male. Age: 18-64 years, 65+ years. Enrolment: 94.
Status: Ongoing, recruiting. Start date (EU): 2021-06-28. Decision date: 2024-08-13. Results received: No. Last updated: 2026-06-22.
Decision dates by country: PL: 2024-09-24, FR: 2024-09-05, PT: 2024-09-25, ES: 2024-08-13, SE: 2024-08-14, DE: 2024-08-19, HU: 2024-08-14, BE: 2024-08-14, SI: 2024-08-21, IT: 2024-09-02, BG: 2024-08-15, CZ: 2024-08-14

Condition(s): BRCA Mutated Ovarian Cancer Patients, Epithelian ovarian cancer, Metastatic Breast Cancer, Platinum Sensitive Relapsed Ovarian Cancer, Patients with gBRCA mutated metastatic pancreatic cancer, prostate cancer, endometrium cancer
Product: Lynparza 100 mg film-coated tablets, Lynparza 150 mg film-coated tablets

Primary endpoint: SAEs and AESIs reported until 30 days after the last dose of study drug.

Source: https://euclinicaltrials.eu/ctis-public/view/2024-512982-15-00